EU clinical trial 2023-509255-14-01: A Phase 2, Open-Label, Single-Arm, Multicentre Study Investigating the Pharmacokinetics, Pharmacodynamics, Efficacy and Safety of Teverelix DP, a Gonadotropin-releasing Hormone (GnRH) Antagonist, in Patients with Advanced Prostate Cancer
Protocol code: ANT-1111-05
Sponsor: Antev Limited, Antev Nordic AB (Pharmaceutical company). Phase: Therapeutic exploratory (Phase II). Countries: Lithuania (authorised, recruitment pending).
Therapeutic area(s): Diseases [C] - Neoplasms [C04]
Gender: Male. Age: 18-64 years, 65+ years. Enrolment: 44.
Status: Authorised, recruitment pending. Decision date: 2024-04-19. Results received: No. Last updated: 2026-07-20.

Condition(s): Advanced prostate cancer
Product: Teverelix TFA, Teverelix TFA

Primary endpoint: The sustained castration rate defined as the cumulative probability of achieving testosterone suppression to castrate levels of ≤ 0.5 ng/mL (1.7 nmol/L) while on study treatment from Study Day 29 through Study Day 155
Endpoint(s): The sustained castration rate, defined as the cumulative probability of testosterone suppression to ≤ 0.2 ng/mL (0.7 nmol/L) while on study treatment from Study Day 29 through Study Day 155

Source: https://euclinicaltrials.eu/ctis-public/view/2023-509255-14-01